EU clinical trial 2025-521514-26-00: A Phase 3, Randomized, Open-label, Multicenter Study to Evaluate the Efficacy and Safety of Sacituzumab Tirumotecan (MK-2870) in Combination With Pembrolizumab With or Without Bevacizumab Compared With Standard of Care as Firstline Maintenance Treatment for Participants With Persistent, Recurrent, or Newly Diagnosed Metastatic Cervical Cancer With PD-L1 CPS Greater Than or Equal to 1 (TroFuse-036/GOG-3123/ENGOT-cx22)
Protocol code: MK-2870-036
Sponsor: Merck Sharp & Dohme LLC (Pharmaceutical company). Phase: Therapeutic confirmatory (Phase III). Countries: Greece (ongoing, recruiting), Ireland (ongoing, recruiting), France (ongoing, recruiting), Belgium (ongoing, recruiting), Czechia (ongoing, recruiting), Hungary (ongoing, recruiting), Austria (ongoing, recruiting), Spain (ongoing, recruiting), Sweden (authorised, recruiting), Germany (ongoing, recruiting), Poland (ongoing, recruiting), Denmark (authorised, recruitment pending), Italy (ongoing, recruiting).
Therapeutic area(s): Diseases [C] - Neoplasms [C04]
Gender: Female. Age: 18-64 years, 65+ years. Enrolment: 317.
Start date (EU): 2026-01-26. Decision date: 2026-01-14. Results received: No. Last updated: 2026-03-10.
Decision dates by country: AT: 2026-01-19, BE: 2026-01-14, CZ: 2026-01-15, DK: 2026-01-15, FR: 2026-01-19, HU: 2026-01-15, IE: 2026-01-16, ES: 2026-01-19, SE: 2026-01-15, PL: 2026-01-19, DE: 2026-01-16, GR: 2026-01-14, IT: 2026-02-27

Condition(s): Persistent, Recurrent, or Newly Diagnosed Metastatic Cervical Cancer With PD-L1 CPS Greater Than or Equal to 1
Product: PACLITAXEL, KEYTRUDA 25 mg/mL concentrate for solution for infusion., Avastin 25 mg/ml concentrate for solution for infusion., MK-2870, MVASI 25 mg/mL concentrate for solution for infusion, CARBOPLATIN, MVASI 25 mg/mL concentrate for solution for infusion, Avastin 25 mg/ml concentrate for solution for infusion., CISPLATIN

Primary endpoint: Part 1 Safety Run-in: Number of Participants Who Experience One or More Adverse Events (AEs), Part 1 Safety Run-in: Number of Participants Who Discontinue Study Treatment Due to an AE, Part 2 Maintenance Treatment: Progression-free Survival (PFS) per Response Evaluation Criteria in Solid Tumors Version 1.1 as Assessed by Blinded Independent Central Review, Part 2 Maintenance Treatment: Overall Survival (OS)
Endpoint(s): Part 2 Maintenance Treatment: Progression-free Survival 2 (PFS2) as Assessed by the Investigator, Part 2 Maintenance Treatment: Number of Participants Who Experience One or More AEs, Part 2 Maintenance Treatment: Number of Participants Who Discontinue Study Treatment Due to an AE, Part 2 Maintenance Treatment: Change from Baseline in European Organisation for Research and Treatment of Cancer Quality of Life Questionnaire-Core 30 (EORTC QLQ-C30) Global Health Status and Quality of Life Combined Score, Part 2 Maintenance Treatment: Change from Baseline in EORTC QLQ-C30 Physical Functioning Combined Score, Part 2 Maintenance Treatment: Change from Baseline in EORTC QLQ-C30 Role Functioning Combined Score, Part 2 Maintenance Treatment: Change from Baseline in EORTC Quality of Life Questionnaire-Cervical Cancer Module (QLQ-CX24) Combined Score

Source: https://euclinicaltrials.eu/ctis-public/view/2025-521514-26-00